EU clinical trial 2024-515951-39-00: An open randomized phase II clinical trial evaluating the safety and efficacy of rapamycin in the treatment of gliomas high-grade malignant gliomas in children as part of the establishment management of rare and ultra rare diseases of the central nervous system associated with mTOR pathway activation: BraimTOR- ONKO
Protocol code: BraimTOR-ONKO
Sponsor: Instytut Pomnik Centrum Zdrowia Dziecka (Hospital/Clinic/Other health care facility). Phase: Therapeutic exploratory (Phase II). Countries: Poland (ended).
Therapeutic area(s): Diseases [C] - Neoplasms [C04]
Gender: Female, Male. Age: 0-17 years. Enrolment: 50.
Status: Ended. Start date (EU): 2023-05-16. End date (EU): 2025-11-27. Decision date: 2025-01-11. Results received: Yes. Last updated: 2025-01-11.

Condition(s): high grade glioma
Product: Rapamune 1 mg/mL oral solution

Primary endpoint: The primary safety endpoint of rapamycin will be the assessment of the incidence of 3 and 4 grade adverse reactions (according to the CTCAE classification) during the treatment phase and follow-up.
Endpoint(s): OS (overall survival) after 15 months, 24 months, 3 years, 5 years, EFS (event free survival) after 15 months, 24 months, 3 years, 5 years, PFS (progression free survival) after 15 months, 24 months, 3 years, 5 years, ORR ( overall response rate) according RAPNO (CR, PR, SD, PD) criteria, Evaluation of adverse event seriousness according CTCAE, Evaluation of the number of patients who experience adverse events that effects with premature termination of tratment during the therapeutic dose period. OS, EFS and PFS will be counted from the start of cancer treatment (the day of surgery).

Source: https://euclinicaltrials.eu/ctis-public/view/2024-515951-39-00